EU clinical trial 2024-512584-31-00: An Evaluation of the Long Term Safety and Efficacy of AAVAnc80-hOTOF Gene Therapy in Individuals with Sensorineural Hearing Loss due to Otoferlin Gene (OTOF) Mutations
Protocol code: AK-OTOF-LTFU
Sponsor: Akouos Inc. (Pharmaceutical company). Phase: Phase II and Phase III (Integrated). Countries: Spain (ongoing, recruiting).
Therapeutic area(s): Diseases [C] - Congenital, Hereditary, and Neonatal Diseases and Abnormalities [C16]
Gender: Female, Male. Age: 0-17 years, 18-64 years, 65+ years. Enrolment: 2.
Status: Ongoing, recruiting. Start date (EU): 2024-11-11. Decision date: 2024-07-24. Results received: No. Last updated: 2026-03-17.

Condition(s): Otoferlin gene-mediated hearing loss
Product: AAVAnc80-hOTOF

Primary endpoint: Safety: Incidence and frequency of AEs, Safety: Concomitant Medications, Safety: Clinical labs: chemistries, hematology (CBC with differential), urinalysis, Safety: Physical examination and vital signs, Safety: Otoscopic examination, Safety: Vestibular screening, Safety: Tympanometry
Endpoint(s): Efficacy: Diagnostic ABR testing threshold, Efficacy: Age-appropriate behavioral audiometry, Efficacy: Standard word or speech recognition testing, Efficacy: Standard auditory questionnaires

Source: https://euclinicaltrials.eu/ctis-public/view/2024-512584-31-00